EU clinical trial 2023-506887-15-00: Fecal Microbiota Transfer in Liver Cancer to Overcome Resistance to Atezolizumab/Bevacizumab – A randomized, placebo-controlled, double-blind Phase II trial (FLORA)
Protocol code: FLORA
Sponsor: Universitaetsklinikum Heidelberg AöR (Hospital/Clinic/Other health care facility). Phase: Therapeutic exploratory (Phase II). Countries: Germany (ongoing, recruiting).
Therapeutic area(s): Diseases [C] - Neoplasms [C04]
Gender: Female, Male. Age: 18-64 years, 65+ years. Enrolment: 48.
Status: Ongoing, recruiting. Start date (EU): 2025-07-14. Decision date: 2024-02-08. Results received: No. Last updated: 2026-05-22.

Condition(s): Hepatocellular carcinoma
Product: Vancomycin Placebo, BEVACIZUMAB, Intestifix 001 placebo, INTESTIFIX 001, ATEZOLIZUMAB, Vancomycin ENTEROCAPS® 250 mg, Hartkapseln

Primary endpoint: The primary immunological patient variable is the count of tumor-infiltrating CD8+ T lymphocytes in the tumor biopsy after two cycles of A/B (d38). CD8+T lymphocyte density will be quantitatively assessed after manual delineation of tumor area in the biopsy (count of CD8+ cells per square millimeter tumor area). Tumor areas with crush artifacts or necrosis will be excluded from analysis., Incidence and severity of AEs and SAEs from treatment start until 42 days after the fourth cycle of A/B (d105). The occurrence of AEs and SAEs is assessed for each patient, including incidence, severity, timing, seriousness, relatedness to study treatment, action taken with study medication and outcome. Detailed information is provided in section 8.

Source: https://euclinicaltrials.eu/ctis-public/view/2023-506887-15-00